EU clinical trial 2023-508132-65-00: Efficacy of methylprednisolone pulses in neuroendocrine cells hyperplasia of infancy: an early phase study (CORTICONEHI).
Protocol code: APHP230821
Sponsor: Assistance Publique Hopitaux De Paris (Hospital/Clinic/Other health care facility). Phase: Therapeutic exploratory (Phase II). Countries: France (ongoing, recruiting).
Therapeutic area(s): Diseases [C] - Respiratory Tract Diseases [C08]
Gender: Female, Male. Age: 0-17 years. Enrolment: 18.
Status: Ongoing, recruiting. Start date (EU): 2025-06-30. Decision date: 2024-06-14. Results received: No. Last updated: 2026-04-09.

Condition(s): NEUROENDOCRINE CELLS HYPERPLASIA OF INFANCY
Product: METHYLPREDNISOLONE, METHYLPREDNISOLONE, METHYLPREDNISOLONE HYDROGEN SUCCINATE, METHYLPREDNISOLONE, METHYLPREDNISOLONE, METHYLPREDNISOLONE, METHYLPREDNISOLONE

Primary endpoint: Number of children still requiring oxygen therapy at M18 (i.e. 18 months after the inclusion)
Endpoint(s): Efficacy endpoint, number of children requiring only sleep oxygen at M18., Efficacy endpoint, number of children with a normal respiratory rate at rest at M18, Efficacy endpoint, difference of Fan’s severity score assessing the severity of children with ILD (respiratory symptoms, SpO2<90% at sleep or exertion, SpO2<90% at rest and pulmonary hypertension) between M0) and M18, Efficacy endpoint, patients and family impact PedsQL and the chILD QoL scores; the chILDPQoL score, a parents QoL score (submitted for publication) at M0 and M18, Efficacy endpoint, number of patients requiring at least one enteral nutrition episode (based on the physician appreciation in case of abnormal weight curve) between M0 and M18, Safety endpoint, number of unexpected hospitalizations for a respiratory exacerbation between M0 and M18, Safety endpoint, number of antibiotic courses for an infectious lung exacerbation between M0 and M18, Safety endpoint, at M6, the number of patients with at least once systolic or diastolic arterial blood pressure (AP) over 2SD for the age at the days of methylprednisolone pulses, Safety endpoints, the number of patients with at least one an elevated fasting glycaemia before the first day of methylprednisolone pulses, Exploratory endpoint, correlation between family impact PedsQL questionnaire and the newly described chILD-PQoL questionnaire at each time of measurement, Exploratory endpoint, number of patients with an extension, a stability, a decrease or an absence of the GGO lesions on the CT-scan at M6 and M18

Source: https://euclinicaltrials.eu/ctis-public/view/2023-508132-65-00